EU clinical trial 2023-510109-16-00: A Phase 2, Randomized, Double-blind, Placebo-controlled Study to Evaluate the Efficacy And Safety Of Adjunctive Recombinant Human Plasma Gelsolin With Standard of Care for Moderate-to-Severe ARDS Due to Pneumonia or Other Infections
Protocol code: BTI-203
Sponsor: Bioaegis Therapeutics Inc. (Pharmaceutical company). Phase: Therapeutic exploratory (Phase II). Countries: Bulgaria (ongoing, recruiting), Netherlands (ongoing, recruiting), Germany (ongoing, recruiting), Czechia (ongoing, recruiting), Hungary (ongoing, recruiting), Italy (ongoing, recruiting), Spain (ongoing, recruiting), Belgium (ongoing, recruiting), Romania (ongoing, recruiting), France (ongoing, recruiting).
Therapeutic area(s): Diseases [C] - Respiratory Tract Diseases [C08]
Gender: Female, Male. Age: 18-64 years, 65+ years. Enrolment: 372.
Status: Ongoing, recruiting. Start date (EU): 2025-01-06. Decision date: 2024-11-18. Results received: No. Last updated: 2026-04-20.
Decision dates by country: HU: 2024-11-22, RO: 2024-11-22, BG: 2024-11-21, DE: 2024-11-19, IT: 2024-11-21, NL: 2024-11-20, ES: 2024-11-19, CZ: 2024-11-20, FR: 2024-11-18, BE: 2024-11-21

Condition(s): Acute Respiratory Distress Syndrome (ARDS) Due to Pneumonia or other Infections
Product: RECOMBINANT HUMAN PLASMA GELSOLIN, Placebo, 0.9% saline solution

Primary endpoint: All-cause mortality at Day 28 between treatment groups
Endpoint(s): Efficacy: Ventilator-free days through Day 28 between treatment groups, Efficacy: All-cause mortality at Day 60 between treatment groups, Efficacy: Proportion of surviving subjects without respiratory support at Day 28 between treatment groups, Efficacy: Time to death and proportions of subjects dying over time (Days 7, 14, and 28) between treatment groups, Efficacy: Proportion of surviving subjects without respiratory support over time (Days 7, 14, and 28) between treatment groups, Efficacy: Time to discontinuation of respiratory support and proportions without respiratory support over time (Days 7, 14, and 28) between treatment groups, Efficacy: For subjects not intubated at entry, the frequency of intubation through Day 28 between treatment groups, Efficacy: To evaluate the days in the ICU and in the hospital through Day 28 between treatment groups, Efficacy: Frequency of RRT through Day 28 between treatment groups, Safety: Incidence, causality, and severity of SAEs and AEs (graded according to the NCI CTCAE version 5.0 [or higher]) in rhu-pGSN vs placebo groups, Safety: New or worsening clinically significant laboratory abnormalities in rhu-pGSN vs placebo groups

Source: https://euclinicaltrials.eu/ctis-public/view/2023-510109-16-00